EU clinical trial 2024-511338-10-01: Oral propranolol for prevention of threshold retinopathy of prematurity
Protocol code: ROPROP
Sponsor: Universitaetsklinikum Tuebingen AöR, Universität Zürich - Klinik für Neonatologie (Hospital/Clinic/Other health care facility, Health care). Phase: Therapeutic exploratory (Phase II). Countries: Germany (ongoing, recruiting).
Therapeutic area(s): Diseases [C] - Congenital, Hereditary, and Neonatal Diseases and Abnormalities [C16]
Gender: Female, Male. Age: 0-17 years. Enrolment: 100.
Status: Ongoing, recruiting. Start date (EU): 2024-07-24. Decision date: 2024-10-24. Results received: No. Last updated: 2025-09-02.

Condition(s): Retinopathy of prematurity
Product: Composition, apart from the active substance, identical to the IMP, PROPRANOLOL HYDROCHLORIDE

Primary endpoint: Survival without threshold ROP (stage 3 or more severe ROP(including aggressive posterior ROP))
Endpoint(s): Time to adverse ophthalmological outcome in days, Ophthalmological outcome categorized as survival without adverse ophthalmological outcome, or death, Survival until 48 weeks PMA without ROP, treated with ablative laser surgery or intravitreal VEGF antagonists, Death until discharge, Death until 48 weeks PMA, ROP retreatment: Need for repeated ROP therapy in infants treated with anti-VEGF-antagonists until 70 (± 2 weeks) PMA

Source: https://euclinicaltrials.eu/ctis-public/view/2024-511338-10-01